EU clinical trial 2024-516724-33-00: Trail aiming to assess the safety and clinical activity of bemarituzumab + bevacizumab in advanced/metastatic gynecological cancer overexpressing FGFR2b
Protocol code: ANGELICA / ET24-224
Sponsor: Centre Leon Berard (Hospital/Clinic/Other health care facility). Phase: Phase I and Phase II (Integrated)- Other. Countries: France (ended).
Therapeutic area(s): Diseases [C] - Neoplasms [C04]
Gender: Female. Age: 18-64 years, 65+ years. Enrolment: 87.
Status: Ended. End date (EU): 2025-11-07. Decision date: 2025-07-08. Results received: No. Last updated: 2025-10-28.

Condition(s): Advanced/metastatic gynecological cancer overexpressing FGFR2b

Source: https://euclinicaltrials.eu/ctis-public/view/2024-516724-33-00